EU clinical trial 2025-522399-10-00: Nordic PREdnisolon for VEstibular NeuriTis Study – an investigator-driven, triple blind, placebo controlled randomized trial
Protocol code: PREVENT
Sponsor: Region Vaesterbotten, Umea University (Hospital/Clinic/Other health care facility, Educational Institution). Phase: Therapeutic confirmatory (Phase III). Countries: Sweden (authorised, recruitment pending), Denmark (authorised, recruitment pending), Norway (authorised, recruitment pending).
Therapeutic area(s): Diseases [C] - Nervous System Diseases [C10]; Diseases [C] - Otorhinolaryngologic Diseases [C09]
Gender: Female, Male. Age: 18-64 years, 65+ years. Enrolment: 404.
Status: Authorised, recruitment pending. Decision date: 2026-02-11. Results received: No. Last updated: 2026-07-24.
Decision dates by country: SE: 2026-02-11, DK: 2026-02-16, NO: 2026-02-16

Condition(s): Vestibular neuritis
Product: Prednisolon Actavis 10 mg tabletter, Laktosmonohydrat SuperTab 11SD

Primary endpoint: The primary outcome measure is the between groups mean vertigo symptom scale short form (VSS-SF) score at 6 weeks after randomization.
Endpoint(s): Comparison of the between groups mean VSS-SF, DHI and EQ-5D-3L scores at 2 weeks after randomization., Comparison of the between groups mean DHI and EQ-5D-3L scores at 6 weeks and 3 and 12 months after randomization, and the between groups VSS-SF at 3 and 12 months after randomization., Comparison of the mean video head impulse test (vHIT) measured lateral canal VOR gain change from baseline to 6 weeks and the change in proportions with saccades from baseline to 6 weeks., Comparison of the between groups mean timed 25-foot walk test (T25-FW) at 6 weeks; the between groups mean body sway during standing and walking at 6 weeks; and the between groups mean number of seconds standing on a foam pad at 6 weeks., BPPV-tests and questionnaires at 6 weeks, comparing proportions with positive tests, and/or questionnaire-positive BPPV between treatment arms., Register-based search for health economic effects on all levels of care (primary, specialized) and society (sick leave).

Source: https://euclinicaltrials.eu/ctis-public/view/2025-522399-10-00